EU clinical trial 2023-506114-49-00: A study of the safety of the new investigational drug CVN293 in healthy volunteers, and how CVN293 is taken up and processed by the human body.
Sponsor: Cerevance Inc. (Pharmaceutical company). Phase: Human Pharmacology (Phase I)- First administration to humans. Countries: Netherlands (ended).
Therapeutic area(s): Diseases [C] - Nervous System Diseases [C10]
Gender: Female, Male. Age: 18-64 years. Enrolment: 64.
Status: Ended. Start date (EU): 2023-08-15. End date (EU): 2024-06-20. Decision date: 2023-08-15. Results received: No. Last updated: 2024-04-15.

Condition(s): Neurodegenerative disorders

Source: https://euclinicaltrials.eu/ctis-public/view/2023-506114-49-00